EU clinical trial 2024-510704-37-00: PADA-1 : Randomized, open label, multicentric phase III trial to evaluate the safety and efficacy of palbociclib in combination with hormone therapy driven by circulating DNA ESR1 mutation monitoring in estrogen receptor-positive, HER2-negative metastatic breast cancer patients
Protocol code: UC-0140/1615
Sponsor: Unicancer (Hospital/Clinic/Other health care facility). Phase: Therapeutic confirmatory (Phase III). Countries: France (ongoing, recruitment ended).
Therapeutic area(s): Diseases [C] - Neoplasms [C04]
Gender: Female. Age: 18-64 years, 65+ years. Enrolment: 1000.
Status: Ongoing, recruitment ended. Start date (EU): 2017-03-22. Decision date: 2024-06-07. Results received: No. Last updated: 2024-06-07.

Condition(s): ER+/HER2- metastatic breast cancer
Product: LETROZOLE, EXEMESTANE, ANASTROZOLE, PALBOCICLIB, FULVESTRANT

Primary endpoint: The Progression-Free Survival (PFS) will be measured from the time of randomization (following rising ESR1 mutation detection) to the time of tumor progression (as assessed by the investigator per RECIST v1.1 criteria (Eisenhauer 2009)) or death (whichever comes first) – in randomized patients. Efficacy analyses will be performed using the local radiologist’s/investigator’s tumor assessments as primary data source., The safety will be assessed by the collection of grade ≥3 adverse events, using the Common Terminology Criteria for Adverse Events (CTCAE), version 4.03 – in all included patients. The co-primary analysis will focus on grade ≥3 hematological toxicities and their associations with baseline characteristics.
Endpoint(s): Progression-Free Survival will be measured from the time of cross-over to the time of tumor progression (as assessed by the investigator per RECIST 1.1) or death (whichever comes first) – in all patients undergoing the crossover., Progression-Free Survival will be measured from the time of inclusion to the time of tumor progression (as assessed by the investigator per RECIST 1.1) or death (whichever comes first) – in all included patients including those switched to fulvestrant., Time to strategy failure will be measured from the time of randomization until palbociclib+endocrine therapy discontinuation or death (whichever comes first)– in all randomized patients., Chemotherapy-free survival will be measured from the time of randomization until the date of chemotherapy initiation or death (whichever comes first)– in all randomized patients. Anticancer treatments received after the study treatment discontinuation will be described., Description of all extra-hematological grade ≥3 toxicities and SAEs incidence rate in the overall population and each treatment step., Overall Survival measured from the date of inclusion to that of the patient’s death – in all included patients., Quality of life score obtained through self-administered QLQ-C30 questionnaire at baseline, at randomization, and every 2 cycles until disease progression (including patients who perform a late switch from arm A to B) or until two years after inclusion whatever the step if patient did not undergo disease progression or rising ctDNA before 2 years., Translational end points : ctDNA detection at different time points.

Source: https://euclinicaltrials.eu/ctis-public/view/2024-510704-37-00